EU clinical trial 2024-514391-41-00: Evaluation of the Effects of Neurexan® on Short-Term Insomnia, Daytime Performance and Stress Response by Polysomnography (PSG), Electroencephalogram (EEG), Stress Biomarkers and Patient-Reported Outcomes (PROs) An Exploratory, Placebo-Controlled Trial in Short-Term Insomnia Patients
Protocol code: C2104
Sponsor: Biologische Heilmittel Heel GmbH (Pharmaceutical company). Phase: Therapeutic exploratory (Phase II). Countries: Germany (ended).
Therapeutic area(s): Psychiatry and Psychology [F] - Behavior and Behavior Mechanisms [F01]
Gender: Female, Male. Age: 18-64 years. Enrolment: 80.
Status: Ended. Start date (EU): 2023-06-16. End date (EU): 2026-02-16. Decision date: 2024-08-07. Results received: No. Last updated: 2025-12-03.

Condition(s): Short-Term Insomnia
Product: Neurexan Tabletten, Placebo to Neurexan Tablet

Primary endpoint: The primary endpoint of this trial is to assess Neurexan® related changes in SE at Visit 2 compared to Baseline 2 as revealed by polysomnography (PSG).
Endpoint(s): Sleep Pattern by • Further objective sleep parameters revealed by polysomnography (PSG) to be assessed as change at Visit 2 compared to Baseline 2 • Objective in-home assessment of sleep pattern revealed by actigraphy (24/7) • Subjective sleep pattern assessed using sleep questionnaires and sleep diary (adapted from Deutsche Gesellschaft für Schlafforschung und Schlafmedizin, DGSM), to be recorded on AMS-ePRO® Daytime Performance by • Resting state EEG; Stress Processing; Blood sampling

Source: https://euclinicaltrials.eu/ctis-public/view/2024-514391-41-00